EU clinical trial 2024-516599-14-00: Safety, Tolerability and Feasibility of Treatment with GP120-activated Regulatory T cells (ATreg) Early After Haematopoietic Stem Cell Transplantation (HSCT) to Reduce the Incidence and Severity of Acute Graft vs Host Disease (GvHD)
Protocol code: ATreg-001
Sponsor: ActiTrexx GmbH (Laboratory/Research/Testing facility). Phase: Phase I and Phase II (Integrated)- First administration to humans. Countries: Germany (ended).
Therapeutic area(s): Diseases [C] - Neoplasms [C04]
Gender: Female, Male. Age: 18-64 years, 65+ years. Enrolment: 10.
Status: Ended. Start date (EU): 2023-12-13. End date (EU): 2026-01-14. Decision date: 2024-10-02. Results received: No. Last updated: 2025-07-21.

Condition(s): Leukaemia

Primary endpoint: Type, incidence, and severity of ATreg-related Serious Adverse Events (SAEs) according to the National Cancer Institute Common Terminology Criteria for Adverse Events (NCI)-(CTCAE) version 5.0 2017 within 24 h, 3 days and 7 days as well as 14 days after ATreg application
Endpoint(s): Incidence of failed ATreg preparations as characterised in the release criteria, Incidence and severity of acute GvHD (Grades II-IV) in ATreg treated patients at days 28, 56 and 90 after ATreg application (day 100 after HSCT), Incidence of severe infections at day 14 after ATreg application, Incidence of relapse at days 28, 56 and 90 after ATreg application (day 100 after HSCT), Change from baseline in neutrophils, platelets, and haemoglobin at day 14 after ATreg application to assess engraftment, Incidence of mortality not based on relapse at day 90 after ATreg application (day 100 after HSCT), Frequency and severity of GvHD at 6 months after ATreg application, Incidence of relapse of the underlying hematologic malignancy at 6 months after ATreg application, Number of systemic infections requiring systemic antibacterial, antiviral or antifungal treatment at 6 months after ATreg application

Source: https://euclinicaltrials.eu/ctis-public/view/2024-516599-14-00